EU clinical trial 2023-506115-17-00: DOSAgE study: A multicenter randomized phase III trial of DOSe-reduced Chemotherapy for Advanced Colorectal Cancer in Older patients
Sponsor: Academisch Ziekenhuis Leiden (Hospital/Clinic/Other health care facility). Phase: Therapeutic confirmatory (Phase III). Countries: Netherlands (ongoing, recruiting).
Therapeutic area(s): Diseases [C] - Neoplasms [C04]
Gender: Female, Male. Age: 65+ years. Enrolment: 587.
Status: Ongoing, recruiting. Start date (EU): 2024-10-14. Decision date: 2024-05-17. Results received: No. Last updated: 2026-07-20.

Condition(s): Metastatic Colorectal Cancer
Product: Capecitabine 500 mg Film-coated Tablets, Fluorouracil 50 mg/ml Solution for injection/infusion, Oxaliplatin 5 mg/ml Concentrate for Solution for infusion, Calcium Folinate 10 mg/ml Solution for injection or infusion

Primary endpoint: Progression-free survival
Endpoint(s): Quality of Life, Physical Functioning, Grade 3-5 chemotherapy-related toxicity, Overall Survival, Number of completed treatment cycles, Dose reductions during treatment, Unplanned hospitalizations, Cumulative received dosage, Cost-effectiveness

Source: https://euclinicaltrials.eu/ctis-public/view/2023-506115-17-00